EU clinical trial 2023-505254-17-00: Painful Inflammatory Carpometacarpal-1 osteoArthritis treated with intraarticular Steroids, Saline or an Occupational therapy intervention: the PICASSO trial
Sponsor: Diakonhjemmet Sykehus AS (Hospital/Clinic/Other health care facility). Phase: Therapeutic use (Phase IV). Countries: Norway (ongoing, recruiting).
Therapeutic area(s): Diseases [C] - Musculoskeletal Diseases [C05]
Gender: Female, Male. Age: 18-64 years, 65+ years. Enrolment: 354.
Status: Ongoing, recruiting. Start date (EU): 2023-11-03. Decision date: 2023-09-29. Results received: No. Last updated: 2025-06-26.

Condition(s): Osteoarthritis in first carpometacarpal joint
Product: Kenacort-T 40 mg/ml, injeksjonsvæske, suspensjon, Natriumklorid Fresenius Kabi 9 mg/ml, oppløsningsvæske til parenteral bruk

Primary endpoint: Change in thumb base joint pain during activities last 24 hours on a Numeric Rating Scale (NRS) after 4 weeks, Change in thumb base joint pain during activities last 24 hours on a Numeric Rating Scale (NRS) after 12 weeks
Endpoint(s): Change in thumb base joint pain during activities last 24 hours on a Numeric Rating Scale (NRS) (all visits), Change in finger joint pain during activities last 24 hours on a Numeric Rating Scale (NRS) (W00, W04, W12, W24, W104), Change in Australian/Canadian Ostearthritis Hand Index (AUSCAN) pain, stiffness and function subscales (W00, W04, W12, W24, W104), Number of OMERACT-OARSI criteria responders (W00, W04, W12, W24, W104), Change in measure of activity performance of the hand (MAP-Hand) (W00, W04, W12, W24, W104), Change in patient-reported overall disease activity in hands last 24 hours on a Numeric Rating Scale (NRS) (W00, W04, W12, W24, W104), Change in assessor-reported overall disease activity in hands on a Numeric Rating Scale (NRS) (W00, W04, W12, W24, W104), Change in pain in finger joints last 24 hours (hand figure) (W00, W04, W12, W24, W104), Change in grip strength (W00, W04, W12, W24, W104), Change in use of analgesics (W00, W04, W12, W24, W104), Change in use of NSAIDs (W00, W04, W12, W24, W104), Change in arthritis self-efficacy scale (W00, W04, W12, W24, W104), Number of responders regarding patient satisfaction (W04, W12), Change in EuroQol 5 dimensions 5-levels (EQ-5D-5L) (W00, W04, W12, W24, W104), Change in number of tender hand joints (W00, W04, W12, W24, W104), Change in number of swollen hand joints (W00, W04, W12, W24, W104), Change in ultrasound synovitis in the CMC-1 joint (W00, W04, W12, W24, INJ, W104), Change in MRI synovitis in the CMC-1 joint on contrast-enhanced MRI (W00, W04), Change in bone marrow lesions in the CMC-1 joint on contrast-enhanced MRI (W00, W04), Change in structural progression by Kellgren-Lawrence (W00, W104), Change in osteophytes by OARSI atlas (W00, W104), Change in joint space narrowing by OARSI atlas (W00, W104), Change in subluxation of the CMC-1 joint (W00, W104), Number of adverse events (W00, W04, W12, W24, INJ, W104), Number of serious adverse events (W00, W04, W12, W24, INJ, W104), Number of withdrawals because of adverse events (W04, W12, W24, INJ, W104), Questions about use of healthcare services (W00, W12, W24, W104), Change in thumb base joint pain at rest last 24 hours on a Numeric Rating Scale (NRS) (W00, W04, W12, W24, W104), Change in finger joint pain at rest last 24 hours on a Numeric Rating Scale (NRS) (W00, W04, W12, W24, W104)

Source: https://euclinicaltrials.eu/ctis-public/view/2023-505254-17-00